EU clinical trial 2023-505572-30-00: OPEN LABEL, FOUR-PERIOD, TWO-SEQUENCE, FULLY-REPLICATED, RANDOMIZED, SINGLE DOSE COMPARATIVE STUDY TO ASSESS BIOEQUIVALENCE OF Polypill AAR 100/80/10 mg capsules FIXED DOSE COMBINATION (TEST) VERSUS EQUAL DOSES OF COADMINISTERED Aspirin® N 100mg tablets + Cardyl® 80mg film-coated tablets + Acovil® 10mg tablets (REFERENCE formulations) IN HEALTHY MALE AND FEMALE VOLUNTEERS UNDER FASTING CONDITIONS
Protocol code: ARA-BESD-14-FRI/23
Sponsor: Ferrer Internacional S.A. (Pharmaceutical company). Phase: Human Pharmacology (Phase I)- Bioequivalence Study. Countries: Romania (ended).
Therapeutic area(s): Diseases [C] - Cardiovascular Diseases [C14]
Gender: Female, Male. Age: 18-64 years, 65+ years. Enrolment: 56.
Status: Ended. Start date (EU): 2023-10-24. End date (EU): 2024-02-02. Decision date: 2023-10-20. Results received: Yes. Last updated: 2023-10-20.

Condition(s): Study performed on healthy volunteers
Product: Cardyl 80 mg comprimidos recubiertos con película, Aspirin® N 100 mg Tablette Acetylsalicylsäure (Ph.Eur.), Cardiovascular Pill AAR, Acovil 10 mg comprimidos

Primary endpoint: Atorvastatin, acetylsalicylic acid and ramipril: AUC0-t and Cmax
Endpoint(s): Atorvastatin and ramipril: Tmax, Atorvastatin and ramipril: AUC0-inf, AUC% extra and t1/2; Acetylsalicylic acid: AUC0-inf, AUC% extra, t1/2, and Tmax

Source: https://euclinicaltrials.eu/ctis-public/view/2023-505572-30-00